EU clinical trial 2025-523600-68-00: A Phase 2 Study of Emavusertib in Combination with an Approved Bruton Tyrosine Kinase Inhibitor in Patients with Chronic Lymphocytic Leukemia and Other B-cell Malignancies
Protocol code: CA-4948-203
Sponsor: Curis Inc. (Pharmaceutical company). Phase: Therapeutic exploratory (Phase II). Countries: Spain (authorised, recruiting), Italy (ongoing, recruiting).
Therapeutic area(s): Diseases [C] - Neoplasms [C04]
Gender: Female, Male. Age: 18-64 years, 65+ years. Enrolment: 40.
Start date (EU): 2026-05-19. Decision date: 2026-03-16. Results received: No. Last updated: 2026-03-16.
Decision dates by country: IT: 2026-03-16, ES: 2026-03-16

Condition(s): Chronic Lymphocytic Leukemia and Other B-cell Malignancies
Product: CA-4948, BRUKINSA 80 mg hard capsules, BRUKINSA 160 mg film-coated tablets, BRUKINSA 160 mg film-coated tablets, CA-4948

Primary endpoint: 1. Cohort 1: undetectable measurable residual disease (uMRD) rate: percentage of patients achieving uMRD as measured in peripheral blood mononuclear cells (PBMCs) by the ClonoSEQ assay. Bone marrow aspirate is required to confirm a CR and uMRD by peripheral blood., 2. Cohort 2: ORR: percentage of patients achieving a complete response (CR), or PR using iwCLL Response Criteria guidelines (Hallek et al, 2018)
Endpoint(s): 1. Cohort 1: Duration of uMRD, Time to measurable residual disease (MRD) conversion, complete response (CR) rate, Duration of CR, Time to CR, 2. Cohort 2: Duration of response (DOR), Time to response, 3. Cohort 1 and Cohort 2: • Progression-free survival (PFS), Overall survival (OS) • Incidence of treatment-emergent adverse events (TEAEs) and treatment-related AEs, physical examinations, vital signs, electrocardiograms (ECGs), and laboratory values • PK parameters: Cmax, Tmax, AUC0-t, and Cmin for emavusertib and zanubrutinib

Source: https://euclinicaltrials.eu/ctis-public/view/2025-523600-68-00